EU clinical trial 2025-522755-26-01: A Phase 2, Randomized, Double-blind, Placebo-controlled Crossover Study Evaluating the Efficacy and Safety of LTG-001 in Patients with Osteoarthritis of the Knee
Protocol code: LTG-001-015
Sponsor: Latigo Biotherapeutics Inc. (Pharmaceutical company). Phase: Therapeutic exploratory (Phase II). Countries: Denmark (authorised, recruitment pending).
Therapeutic area(s): Diseases [C] - Musculoskeletal Diseases [C05]
Gender: Female, Male. Age: 18-64 years, 65+ years. Enrolment: 180.
Status: Authorised, recruitment pending. Decision date: 2025-11-10. Results received: No. Last updated: 2025-11-10.

Condition(s): Osteoarthritis of the knee
Product: Matched placebo for the IMP, LTG-001 tablet

Primary endpoint: Change in WOMAC pain subscale score from pre-dose at the start of each treatment period (Day 1, Day 28) to the end of each treatment period (Day 14, Day 41).
Endpoint(s): Change from baseline (7-day diary run-in) in weekly mean Average and Worst Pain score (via average and worst pain NPRS) each week of each treatment period (Period 1 Week 1 [Days 1-6], Period 1 Week 2 [Days 7-13], Period 2 Week 1 [Days 28-33], Period 2 Week 2 [Days 34-40])., Change in WOMAC physical function subscale score from pre-dose at the start of each treatment period (Day 1, Day 28) to the end of each treatment period (Day 14, Day 41)., Change in participant assessment of pain score during StEPP from pre-dose at the start of each treatment period (Day 1, Day 28) to the end of each treatment period (Day 14, Day 41)., Change in WOMAC stiffness subscale score from pre-dose at the start of each treatment period (Day 1, Day 28) to the end of each treatment period (Day 14, Day 41)., PGA score at the end of each treatment period (Day 14, Day 41)., Proportion of participants with favorable (rating of “good,” “very good” or “excellent”) PGA of study drug at the end of each treatment period (Day 14, Day 41)., Total rescue medication use for target knee during each treatment period., Incidence, severity, and relatedness of TEAEs, SAEs, discontinuations due to TEAEs, and deaths., Change from baseline in vital signs, ECG, and laboratory test values., Plasma concentrations of LTG-001 and its metabolites after the first and last dose of study drug in the active treatment period.

Source: https://euclinicaltrials.eu/ctis-public/view/2025-522755-26-01